EU clinical trial 2025-520801-12-00: Inhibition of late sodium current (INa) to prevent coronary MICROvascular dysfunction in patients presenting with ST-Elevation myocardial infarction and multivessel disease: A multicenter, randomized, controlled and open label study (INaMICRON study)
Protocol code: INAMICRON
Sponsor: Universita' Degli Studi Di Napoli Federico II (Educational Institution). Phase: Therapeutic exploratory (Phase II). Countries: Italy (ongoing, recruiting).
Therapeutic area(s): Diseases [C] - Cardiovascular Diseases [C14]
Gender: Female, Male. Age: 18-64 years, 65+ years. Enrolment: 100.
Status: Ongoing, recruiting. Start date (EU): 2026-03-03. Decision date: 2025-10-13. Results received: No. Last updated: 2025-11-25.

Condition(s): Acute myocardial infarction in patients presenting with STEMI and multivessel disease.
Product: RANOLAZINE, RANOLAZINE

Primary endpoint: The relative difference in terms of IMR and/or angioIMR will be evaluated. IMR and/or angioIMR will be assessed both at the baseline (after successful coronary revascularization) and at the time of staged revascularization of the non-culprit stenosis (either at 5+/-2 days or within 6+/-2 weeks after pPCI).
Endpoint(s): The prevalence of residual CMD downstream to the culprit vessel in the two group of patients. Residual CMD will be defined as the finding of an IMRculprit or angioIMRculprit value > 25, The extent of the Infarct Size, as assessed by the CMR, in terms of grams (g) and percentage as compared with control group., The prevalence of CMD downstream to the non-culprit vessel in the two group of patients (CMDnon-culprit). CMDnon-culprit will be defined as the finding of an IMRnon-culprit or angioIMRnon-culprit value > 25, The incidence of peri-procedural CMD after staged PCI of the non-culprit stenoses, defined as a 20% increase of IMRnon-culprit or angioIMRnon-culprit values assessed before and after elective PCI of the non-culprit vessel., The difference between the two groups of patients, in terms of incidence of periprocedural Myocardial Infarction (PMI), eventually occurring during the staged procedure. PMI require to satisfy all the criteria of the fourth Universal Definition of Myocardial Infarction, The effects of INa current inhibition on endothelial function will be assessed at follow up as compared with control group. Endothelial function will be evaluated with the EndoPAT, measuring both the Endoscore and RHI, The incidence of MACE, defined as composite of death, myocardial infarction, or target-vessel revascularization at short (42+/-7 days) term follow-up., Angina symptoms and quality of life will be assessed with SAQ7 and EuroQoL questionnaires and results compared between the two groups

Source: https://euclinicaltrials.eu/ctis-public/view/2025-520801-12-00